EU clinical trial 2024-516296-32-00: A Randomized, Open-Label, Phase 1-2 Study of ASTX727 Low Dose (ASTX727 LD) Extended Schedule in Subjects with Lower Risk (IPSS Low or Intermediate-1) Myelodysplastic Syndromes (MDS)
Protocol code: ASTX727-03
Sponsor: Taiho Oncology Inc. (Pharmaceutical company). Phase: Human Pharmacology (Phase I)- Other. Countries: Spain (ended), Belgium (ended), Germany (ended).
Therapeutic area(s): Diseases [C] - Hemic and Lymphatic Diseases [C15]
Gender: Female, Male. Age: 18-64 years, 65+ years. Enrolment: 24.
Status: Ended. Start date (EU): 2021-11-11. End date (EU): 2025-11-18. End date: 2026-01-13. Decision date: 2024-09-25. Results received: No. Last updated: 2025-09-08.
Decision dates by country: ES: 2024-09-25, DE: 2024-09-27, BE: 2024-09-27

Condition(s): Myelodysplastic Syndromes (MDS)
Product: ASTX727, ASTX727, Decitabine, ASTX727

Primary endpoint: Phase 1 - Safety as determined by incidence of drug-related Grade ≥3 AEs or dose-limiting toxicities (DLTs) (if any) for each cohort dose/schedule., Phase 2 - Hematologic response as defined in the Efficacy Analysis section (Section 11.6.1 of study protocol).
Endpoint(s): %LINE-1 methylation change from baseline, PK parameters, including area under the curve (AUC), maximum concentration (Cmax), Tmax, and t1/2 of decitabine, cedazuridine, and cedazuridine-epimer in the first cycle of treatment, Safety as determined by incidence of AEs, AEs of Grade ≥3, and serious adverse events (SAEs) (Primary endpoint for Phase 1), Hematologic response (Secondary endpoint for Phase 1 only), HbF induction compared with baseline to >1% from ≤1%, or increase of 50% in subjects with ≥1% at baseline in at least 2 successive measurements, RBC transfusion independence, as defined in Section 11.6.2 of study protocol., Platelet transfusion independence, as defined in Section 11.6.3 of study protocol., Overall response rate (ORR): complete response (CR), marrow complete response (mCR), and hematologic improvement (HI) based on International Working Group IIWG) 2006 MDS response criteria, as defined in Section 11.6.4 of study protocol., Time to bone marrow blasts >5%, defined as the number of days from the date of randomization to the date when bone marrow blasts are >5% and increased by ≥50%, Leukemia-free survival, defined as the number of days from the date of randomization to the date when bone marrow or peripheral blood blasts reach ≥20%, or death from any cause, Overall survival (OS), defined as the number of days from the date of randomization to the date of death from any cause

Source: https://euclinicaltrials.eu/ctis-public/view/2024-516296-32-00